EU clinical trial 2024-514447-29-00: Bioequivalence of Metamizole Sodium 500 mg Film-Coated Tablets in Healthy Participants Under Fasting Conditions.
Protocol code: b4-23-TEMt
Sponsor: Alkaloid AD Skopje (Pharmaceutical company). Phase: Human Pharmacology (Phase I)- Bioequivalence Study. Countries: Portugal (ended).
Therapeutic area(s): Not possible to specify
Gender: Female, Male. Age: 18-64 years. Enrolment: 30.
Status: Ended. Start date (EU): 2024-12-02. End date (EU): 2024-12-26. Decision date: 2024-11-26. Results received: No. Last updated: 2024-12-26.
Decision dates by country: PT: 2024-12-06

Condition(s): No medical condition.

Source: https://euclinicaltrials.eu/ctis-public/view/2024-514447-29-00